EU clinical trial 2025-524274-41-00: OPEN-LABEL PALATABILITY STUDY OF A NOVEL ORODISPERSIBLE PARACETAMOL/IBUPROFEN FORMULATION AFTER A SINGLE ORAL ADMINISTRATION IN HEALTHY SUBJECTS
Protocol code: FMLD-HUNGRIA-68_PALA
Sponsor: Farmalider S.A. (Pharmaceutical company). Phase: Human Pharmacology (Phase I)- Other. Countries: Spain (ended).
Therapeutic area(s): Not possible to specify
Gender: Female, Male. Age: 18-64 years. Enrolment: 14.
Status: Ended. Start date (EU): 2026-01-26. End date (EU): 2026-02-25. Decision date: 2026-01-14. Results received: No. Last updated: 2026-01-14.

Condition(s): Healthy volunteers

Source: https://euclinicaltrials.eu/ctis-public/view/2025-524274-41-00